EU clinical trial 2025-523428-39-00: A phase II, multicenter study of GlOfitamab in patients with mantle cell Lymphoma and inaDequate response or relapse following CAR T-cell therapy (GOLD)
Sponsor: Fondazione Italiana Linfomi Ets (Patient organisation/association). Phase: Therapeutic exploratory (Phase II). Countries: Italy (ongoing, recruiting).
Therapeutic area(s): Diseases [C] - Hemic and Lymphatic Diseases [C15]
Gender: Female, Male. Age: 18-64 years, 65+ years. Enrolment: 41.
Status: Ongoing, recruiting. Start date (EU): 2026-06-05. Decision date: 2026-04-14. Results received: No. Last updated: 2026-06-23.

Condition(s): Mantle Cell Lymphoma
Product: GLOFITAMAB, TOCILIZUMAB, GLOFITAMAB, OBINUTUZUMAB

Primary endpoint: Complete Response Rate (CRR) at any time during study treatment (assessed by the independent review committee according to Lugano 2014 criteria)
Endpoint(s): Overall Response Rate (ORR) defined as the proportion of patients achieving either a Complete Response (CR) or Partial Response (PR) (assessed by the independent review committee according to Lugano 2014 criteria), and evaluated at C6 and C12, Complete Response Rate (CRR) at the end of treatment (C12) (assessed by the independent review committee according to Lugano 2014 criteria), Progression Free Survival (PFS) defined as the time from the study inclusion to disease progression or death from any cause, Overall Survival (OS) defined as the time between the study inclusion and death from any cause, Duration of Response (DOR) defined as the time from the first documentation of tumor response (Complete or Partial Response) to disease progression or death, Time to Next Treatment (TTNT) defined as the time represents the interval from the study inclusion to initiation of the next line of therapy., Event Free Survival (EFS) defined as the time from the study inclusion to disease progression, death, or Next Anti-Lymphoma Treatment (NALT) start., Frequency and severity of adverse events (AEs) classified as per CTCAE latest version and SAE

Source: https://euclinicaltrials.eu/ctis-public/view/2025-523428-39-00